EU clinical trial 2024-512891-37-00: A controlled phase II clinical trial evaluating the safety and efficacy of myelin peptide-loaded tolDC as treatment for Multiple Sclerosis
Sponsor: Antwerp University Hospital (Hospital/Clinic/Other health care facility). Phase: Therapeutic exploratory (Phase II). Countries: Spain (ended), Belgium (ended).
Therapeutic area(s): Diseases [C] - Immune System Diseases [C20]
Gender: Female, Male. Age: 18-64 years. Enrolment: 48.
Status: Ended. End date (EU): 2025-11-06. Decision date: 2024-11-22. Results received: No. Last updated: 2024-11-25.
Decision dates by country: BE: 2024-11-22, ES: 2024-11-25

Condition(s): Multiple Sclerosis
Product: tolDC

Primary endpoint: Efficacy will be determined by evaluating the number of new and enlarging T2 lesions on MRI scans
Endpoint(s): The number and severity of adverse events, Proportion of relapse-free patients, Changes in relapse rate (compared with the year before inclusions), Changes from baseline in mean EDDS scores and supplementary ambulatory clinical outcome measures, change from baseline in T1 Gd and T2 lesion load, atrophy, and total brain volume on MRI scans

Source: https://euclinicaltrials.eu/ctis-public/view/2024-512891-37-00